EU clinical trial 2023-509723-41-01: A Phase I Clinical Trial of CART cell therapy for refractory/ relapsed acute lymphoblastic leukemia with unmet needs in children, adolescents and young adults: feasibility and safety study (REALL_CART).
Protocol code: REALL_ CART
Sponsor: Fundacion Para La Investigacion Biomedica Del Hospital Universitario La Paz (Patient organisation/association). Phase: Human Pharmacology (Phase I)- Other. Countries: Spain (ongoing, recruiting).
Therapeutic area(s): Diseases [C] - Neoplasms [C04]
Gender: Female, Male. Age: 0-17 years, 18-64 years. Enrolment: 10.
Status: Ongoing, recruiting. Start date (EU): 2025-06-16. Decision date: 2024-11-19. Results received: No. Last updated: 2026-08-03.

Condition(s): Refractory/ relapsed acute lymphoblastic leukemia in children, adolescents and young adults.
Product: CART 19/22 T CELLS, CART45RA-NKG2D CELLS

Primary endpoint: In this umbrella trial, we will determine in parallel within independent cohorts: 1- The safety and feasibility of autologous CART-19/22 in children, adolescents and young adults with a CD19+/- CD22+ relapse/ refractory disease for a r/r B-ALL. 2- The safety and feasibility of allogeneic CART-NKG2D T in children, adolescents and young adults with r/r T-ALL.
Endpoint(s): Expression of CD19/CD22 and NKG2DL on primary B- or T- cell ALL, respectively., Persistence of CART19/22 and CARTs-NKG2D cells in patients’ samples (peripheral blood, bone marrow, cerebrospinal fluid)., Peripheral blood cytokine profile from the patients’ serum., Identify the DNA methylation profile of NKG2DL (MICA, MICB AND ULBPs 1-3) in primary T-cell malignancies’ samples., Evaluate the presence of soluble NKG2DL and ANTI-MICA and ANTI-MICB antibodies in the serum of patients under CART-NKG2D therapy., Overall rate response in both arms.

Source: https://euclinicaltrials.eu/ctis-public/view/2023-509723-41-01